EU clinical trial 2024-511536-27-00: Plasma cell depletion as an approach to reset autoimmunity in rheumatoid arthritis
Protocol code: CURACTA
Sponsor: Charite Universitaetsmedizin Berlin KöR (Hospital/Clinic/Other health care facility). Phase: Phase I and Phase II (Integrated)- Other. Countries: Germany (ongoing, recruiting).
Therapeutic area(s): Diseases [C] - Musculoskeletal Diseases [C05]
Gender: Female, Male. Age: 18-64 years, 65+ years. Enrolment: 23.
Status: Ongoing, recruiting. Start date (EU): 2025-03-11. Decision date: 2024-03-13. Results received: No. Last updated: 2025-08-11.

Condition(s): Rheumatoid arthritis
Product: DARZALEX 1800 mg solution for injection, ORENCIA 125 mg solution for injection in pre-filled syringe, ORENCIA 125 mg solution for injection in pre-filled pen

Primary endpoint: Incidence and grading of severity of Injection Related Reactions (IRR) and toxicity after administration of daratumumab until week 12, AE and SAE due to IMP (both, daratumumab and abatacept) throughout the whole study, Percentage of subjects with ACPA seroconversion (below the laboratory reference level for positivity)

Source: https://euclinicaltrials.eu/ctis-public/view/2024-511536-27-00